EU clinical trial 2023-505286-84-00: Randomized phase 2 trial of two chemotherapy regimens plus or minus bevacizumab in patients with well differentiated pancreatic neuroendocrine tumors
Protocol code: CSET N° 2017/2523
Sponsor: Institut Gustave Roussy (Hospital/Clinic/Other health care facility). Phase: Therapeutic exploratory (Phase II). Countries: France (ongoing, recruitment ended).
Therapeutic area(s): Diseases [C] - Hormonal diseases [C19]; Analytical, Diagnostic and Therapeutic Techniques and Equipment [E] - Investigative Techniques [E05]
Gender: Female, Male. Age: 18-64 years. Enrolment: 140.
Status: Ongoing, recruitment ended. Start date (EU): 2018-06-25. Decision date: 2024-03-27. Results received: No. Last updated: 2024-03-27.

Condition(s): Pancreatic well differentiated neuroendocrine tumors (NET)

Source: https://euclinicaltrials.eu/ctis-public/view/2023-505286-84-00